EU clinical trial 2024-518237-28-00: Ursodeoxycolic acid for the prevention of relapsing complications after gallstone acute pancreatitis, a double-blind multicenter randomized-controlled trial.
Sponsor: Hospital General Universitario Dr. Balmis (Hospital/Clinic/Other health care facility). Phase: Therapeutic use (Phase IV). Countries: Spain (authorised, recruitment pending).
Therapeutic area(s): Diseases [C] - Digestive System Diseases [C06]
Gender: Female, Male. Age: 18-64 years, 65+ years. Enrolment: 332.
Status: Authorised, recruitment pending. Decision date: 2024-12-04. Results received: No. Last updated: 2024-12-04.

Condition(s): recurrence of acute biliary pancreatitis
Product: URSOBILANE 300 mg cápsulas., Excipiente número 1 para cápsulas 500 gramos

Primary endpoint: Death and / or complication associated with gallstones (new episode of PAB, cholangitis, cholecystitis, choledocholithiasis or biliary colic, variable based on the primary endpoint of the PONCHO clinical trial (1)), until cholecystectomy is performed or until 1 year.

Source: https://euclinicaltrials.eu/ctis-public/view/2024-518237-28-00